EU clinical trial 2024-517512-30-00: A first-in-human study to learn about how safe the study drug is in healthy participants
Protocol code: 22819
Sponsor: Bayer AG (Pharmaceutical company). Phase: Human Pharmacology (Phase I)- First administration to humans. Countries: Germany (ended).
Therapeutic area(s): Diseases [C] - Cardiovascular Diseases [C14]
Gender: Female, Male. Age: 18-64 years, 65+ years. Enrolment: 210.
Status: Ended. Start date (EU): 2025-04-28. End date (EU): 2025-11-24. Decision date: 2025-03-21. Results received: No. Last updated: 2025-11-11.
Decision dates by country: DE: 2025-03-24

Condition(s): Cardiac arrhythmia

Source: https://euclinicaltrials.eu/ctis-public/view/2024-517512-30-00